EU clinical trial 2025-521705-40-00: A study to Learn How Safe AGMB-129 is in Healthy Adults Taking Multiple Doses of AGMB-129 That Are Increased a Little at a Time
Protocol code: AGMB129-01-CL-109
Sponsor: Agomab Spain S.L.U. (Pharmaceutical company). Phase: Human Pharmacology (Phase I)- Other. Countries: Belgium (ended).
Therapeutic area(s): Diseases [C] - Digestive System Diseases [C06]
Gender: Female, Male. Age: 18-64 years. Enrolment: 40.
Status: Ended. Start date (EU): 2025-07-18. End date (EU): 2025-09-15. Decision date: 2025-06-26. Results received: No. Last updated: 2025-09-17.

Condition(s): Fibrostenotic Crohn’s disease

Source: https://euclinicaltrials.eu/ctis-public/view/2025-521705-40-00